EU clinical trial 2022-501119-14-01: A Phase 2, Double-Blinded, Randomized, Placebo-Controlled, Dose-Ranging Study Evaluating the Efficacy and Safety of GS-5290 in Participants With Moderately to Severely Active Ulcerative Colitis
Protocol code: GS-US-457-6411
Sponsor: Gilead Sciences Inc. (Pharmaceutical company). Phase: Therapeutic exploratory (Phase II). Countries: France (ongoing, recruiting), Hungary (ongoing, recruiting), Germany (ongoing, recruiting), Austria (ongoing, recruiting), Poland (ongoing, recruiting), Belgium (ongoing, recruiting), Italy (ongoing, recruiting).
Therapeutic area(s): Diseases [C] - Digestive System Diseases [C06]
Gender: Female, Male. Age: 18-64 years, 65+ years. Enrolment: 78.
Status: Ongoing, recruiting. Start date (EU): 2024-04-16. Decision date: 2023-09-22. Results received: No. Last updated: 2026-06-24.
Decision dates by country: HU: 2023-09-25, AT: 2023-09-26, DE: 2023-09-22, BE: 2023-09-25, IT: 2023-09-26, FR: 2023-09-22, PL: 2023-09-26

Condition(s): Ulcerative Colitis
Product: PTM GS‑5290 tablets 300 mg, GS-5290 tablets 300 mg, GS-5290 tablets 150 mg, PTM GS‑5290 tablets 150 mg

Primary endpoint: Clinical Response, defined as a decrease from baseline of ≥ 2 points and at least 30% in 3 components of the modified Mayo Clinic Score (MCS), Stool Frequency, Rectal Bleeding, and Endoscopic Findings, in addition to a ≥ 1 point decrease from baseline in the Rectal Bleeding subscore or Rectal Bleeding subscore of ≤ 1 at Week 12
Endpoint(s): Clinical Remission, defined as a Stool Frequency subscore ≤ 1 and not greater than baseline, Rectal Bleeding subscore of 0, and Endoscopic Findings subscore ≤ 1 at Week 12, Endoscopic Response, defined as an Endoscopic Findings subscore ≤ 1 at Week 12, Histologic Endoscopic Mucosal Improvement, defined as an Endoscopic Findings subscore ≤ 1 and Geboes score < 3.1 (indicating neutrophil infiltration in < 5% of crypts, no crypt destruction and no erosions, ulcerations, or granulation tissue) at Week 12

Source: https://euclinicaltrials.eu/ctis-public/view/2022-501119-14-01